EU clinical trial 2022-502839-19-00: J2A-MC-GZGP A Phase 3, Randomized, Double-Blind Study to Investigate the Efficacy and Safety of Once-Daily Oral Orforglipron Compared With Placebo in Adult Participants With Obesity or Overweight With Weight-Related Comorbidities (ATTAIN-1)
Protocol code: J2A-MC-GZGP
Sponsor: Eli Lilly & Co. (Pharmaceutical company). Phase: Therapeutic confirmatory (Phase III). Countries: Slovakia (ongoing, recruitment ended), Spain (ongoing, recruitment ended).
Therapeutic area(s): Diseases [C] - Nutritional and Metabolic Diseases [C18]
Gender: Female, Male. Age: 18-64 years, 65+ years. Enrolment: 516.
Status: Ongoing, recruitment ended. Start date (EU): 2023-09-14. Decision date: 2023-09-04. Results received: No. Last updated: 2025-12-01.
Decision dates by country: SK: 2023-09-04, ES: 2023-09-06

Condition(s): Obesity, Overweight, Overweight or Obesity
Product: Sodium Bicarbonate - Placebo to match LY3502970, ORFORGLIPRON, ORFORGLIPRON, ORFORGLIPRON, ORFORGLIPRON, ORFORGLIPRON, Orforglipron

Primary endpoint: Mean Percent Change from Baseline in Body Weight [Time Frame: Baseline to Week 72]

Source: https://euclinicaltrials.eu/ctis-public/view/2022-502839-19-00